EU clinical trial 2023-506044-16-00: A study to investigate the mass balance, absolute bioavailability (BA), pharmacokinetics (PK), and metabolism of a single oral dose 60 mg [14C]-alogabat and an IV microdose of 100 μg [13C]-alogabat
Protocol code: BP41817
Sponsor: F. Hoffmann-La Roche AG (Pharmaceutical company). Phase: Human Pharmacology (Phase I)- Other. Countries: Netherlands (ended).
Therapeutic area(s): Diseases [C] - Nervous System Diseases [C10]; Psychiatry and Psychology [F] - Behavioral Disciplines and Activities [F04]
Gender: Male. Age: 18-64 years. Enrolment: 8.
Status: Ended. Start date (EU): 2023-12-14. End date (EU): 2024-03-15. End date: 2024-03-15. Decision date: 2023-10-26. Results received: No. Last updated: 2023-12-01.

Condition(s): There is no medical condition being investigated., Not applicable (NA)

Source: https://euclinicaltrials.eu/ctis-public/view/2023-506044-16-00